EU clinical trial 2025-523375-29-00: Sodium-glucose cotransporter-2 inhibitors to stABiLizE coronary atherosclerosis pro-gression after acute Myocardial Infarction in women and men with diabetes mellitus
Sponsor: Humanitas Mirasole S.p.A. (Hospital/Clinic/Other health care facility). Phase: Therapeutic confirmatory (Phase III). Countries: Italy (ongoing, recruiting).
Therapeutic area(s): Diseases [C] - Cardiovascular Diseases [C14]; Diseases [C] - Nutritional and Metabolic Diseases [C18]
Gender: Female, Male. Age: 18-64 years, 65+ years. Enrolment: 300.
Status: Ongoing, recruiting. Start date (EU): 2026-07-21. Decision date: 2026-02-06. Results received: No. Last updated: 2026-07-20.

Condition(s): diabetes mellitus, Myocardial Infarction
Product: Jardiance 10 mg film-coated tablets, Forxiga 10 mg film-coated tablets, Invokana 100 mg film-coated tablets, Invokana 300 mg film-coated tablets, Forxiga 5 mg film-coated tablets, Jardiance 25 mg film-coated tablets

Primary endpoint: The primary endpoint will be the change in total coronary percentage atheroma volume (PAV) on native (untreated) segments assessed by coronary CT angiography (CCTA) from baseline to 12 months follow-up. Change in PAV is defined as the difference between PAV at baseline and PAV at 12 months follow-up (PAV change = baseline PAV - 12 months PAV).
Endpoint(s): The secondary endpoints will include: inflammatory biomarkers, biochemical markers of glycaemic control, features of high-risk plaque composition evaluated at CCTA, degree of neointimal hyper-plasia on treated coronary segments at CCTA, adherence to therapy.

Source: https://euclinicaltrials.eu/ctis-public/view/2025-523375-29-00